EU clinical trial 2023-510074-13-00: A clinical trial to determine if AIC263029 is safe when dosed only once or several times, and to investigate how it moves within the human body
Protocol code: AIC468-01-I-01
Sponsor: AiCuris Anti-infective Cures AG (Pharmaceutical company). Phase: Human Pharmacology (Phase I)- First administration to humans. Countries: Germany (ended).
Therapeutic area(s): Diseases [C] - Virus Diseases [C02]
Gender: Female, Male. Age: 18-64 years. Enrolment: 104.
Status: Ended. Start date (EU): 2024-10-02. End date (EU): 2026-03-16. Decision date: 2024-03-15. Results received: No. Last updated: 2025-10-10.

Condition(s): BKV-associated nephropathy

Source: https://euclinicaltrials.eu/ctis-public/view/2023-510074-13-00